EU clinical trial 2023-505613-24-00: A Phase 2, Open-Label, Single-Arm, Sequential-Panel Study to Evaluate the Pharmacokinetics, Safety, and Tolerability of Posaconazole (POS, MK-5592) Intravenous and Powder for Oral Suspension Formulations in Pediatric Participants From Birth to Less Than 2 Years of Age With Possible, Probable, or Proven Invasive Fungal Infection
Protocol code: MK-5592-127
Sponsor: Merck Sharp & Dohme LLC (Pharmaceutical company). Phase: Therapeutic exploratory (Phase II). Countries: Poland (temporarily halted), Belgium (temporarily halted), Greece (temporarily halted).
Therapeutic area(s): Diseases [C] - Bacterial Infections and Mycoses [C01]
Gender: Female, Male. Age: 0-17 years. Enrolment: 13.
Status: Temporarily halted. Start date (EU): 2021-04-28. Decision date: 2024-04-12. Results received: No. Last updated: 2025-08-19.
Decision dates by country: BE: 2024-04-15, PL: 2024-04-12, GR: 2024-06-17

Condition(s): Fungal infection
Product: Noxafil 300 mg concentrate for solution for infusion, Posaconazole, Posaconazole

Primary endpoint: Average concentration (Cavg) of single-dose IV POS (Panel A), Maximum concentration (Cmax) of single-dose IV POS (Panel A), Time to maximum concentration (Tmax) of single-dose IV POS (Panel A), Area under the plasma concentration-time curve from dosing to 24 hours postdose (AUC0-24) of single-dose IV POS (Panel A), Clearance (CL) of single-dose IV POS (Panel A), Area under the plasma concentration-time curve from dosing to infinity (AUC0-∞) of single-dose IV POS (Panel A), Cavg of multiple-dose IV POS (Panel B), Cmax of multiple-dose IV POS (Panel B), Tmax of multiple-dose IV POS (Panel B), AUC0-24 of multiple-dose IV POS (Panel B), CL of multiple-dose IV POS (Panel B), Cavg of multiple-dose PFS (Panel B), Cmax of multiple-dose PFS (Panel B), AUC0-24 of multiple-dose PFS (Panel B)
Endpoint(s): Cavg of IV POS in neonates and infants <2 years of age compared to adults and older pediatric populations (Panel B only), Percentage of participants with ≥1 adverse events (AEs) [Panels A and B], Percentage of participants with ≥1 drug-related AEs (Panels A and B), Percentage of participants discontinuing from study treatment due to AE(s) (Panels A and B), Percentage of participants with all-cause mortality through 28 days (Panel B), Percentage of participants with need for systemic antifungal therapy (other than POS) during the study period [Panel B]

Source: https://euclinicaltrials.eu/ctis-public/view/2023-505613-24-00